EU clinical trial 2023-508191-11-00: A Multicenter, Randomized, Double-Blind, Placebo-Controlled, Parallel-Group Study to Evaluate the Efficacy and Safety of Dapirolizumab Pegol in Study Participants With Moderately to Severely Active Systemic Lupus Erythematosus
Protocol code: SL0044
Sponsor: UCB Biopharma (Pharmaceutical company). Phase: Therapeutic confirmatory (Phase III). Countries: Denmark (ongoing, recruiting), Spain (ongoing, recruiting), Germany (ongoing, recruiting), France (ongoing, recruiting), Italy (ongoing, recruiting), Greece (ongoing, recruiting), Poland (ongoing, recruiting), Belgium (ongoing, recruiting), Netherlands (authorised, recruitment pending).
Therapeutic area(s): Phenomena and Processes [G] - Immune system processes [G12]
Gender: Female, Male. Age: 0-17 years, 18-64 years, 65+ years. Enrolment: 109.
Start date (EU): 2024-11-28. Decision date: 2023-12-08. Results received: No. Last updated: 2026-07-30.
Decision dates by country: FR: 2023-12-19, ES: 2023-12-11, IT: 2023-12-21, PL: 2024-02-23, NL: 2024-11-19, GR: 2024-02-05, BE: 2024-10-11, DE: 2023-12-08, DK: 2023-12-08

Condition(s): Systemic lupus erythematosus (SLE)
Product: PARACETAMOL, EPINEPHRINE, Placebo matching dapirolizumab pegol and without active substance, DIPHENHYDRAMINE, Dapirolizumab pegol

Primary endpoint: Achievement of British Isles Lupus Assessment Group Disease Activity Index 2004 (BILAG 2004)-based Composite Lupus Assessment (BICLA) response at Week 48
Endpoint(s): Achievement of SRI 4 response at Week 48, Achievement of prevention of severe BILAG flares (severe BILAG flare-free) through Week 48, Achievement of LLDAS at Week 40 and maintaining LLDAS at Weeks 44 and 48, Change from Baseline to Week 48 in the FATIGUE-PRO Total score, Percentage of participants having a reduction in glucocorticoid dose from >7.5mg/day prednisone-equivalent dose at Baseline to ≤7.5mg/day at Week 36 and maintained through Week 48, Achievement of BILAG 2004 improvement without worsening at Week 48, Change from Baseline in PGA at Week 48, Achievement of prevention of moderate/severe BILAG flares (moderate/severe BILAG flare-free) through Week 48, Change from Baseline in SLEDAI-2K at Week 48, Change from Baseline in FACIT-Fatigue score at Week 48, Percentage of participants with treatment-emergent adverse events (TEAEs) during the study, Percentage of participants with serious treatment-emergent adverse events during the study, Percentage of participants with treatment-emergent adverse events of special interest during the study, Percentage of participants with treatment-emergent adverse events of special monitoring during the study

Source: https://euclinicaltrials.eu/ctis-public/view/2023-508191-11-00